EU clinical trial 2023-509201-77-00: An Open-Label, Long Term Safety and Efficacy Study of Donidalorsen in the Prophylactic Treatment of Hereditary Angioedema (HAE).
Protocol code: ISIS 721744-CS7
Sponsor: Ionis Pharmaceuticals Inc. (Pharmaceutical company). Phase: Therapeutic confirmatory (Phase III). Countries: Germany (ongoing, recruitment ended), Bulgaria (ongoing, recruitment ended), Netherlands (ongoing, recruitment ended), Poland (ongoing, recruitment ended), Spain (ongoing, recruitment ended), Belgium (ongoing, recruitment ended), France (ongoing, recruitment ended), Italy (ongoing, recruitment ended).
Therapeutic area(s): Phenomena and Processes [G] - Genetic Phenomena [G05]; Diseases [C] - Congenital, Hereditary, and Neonatal Diseases and Abnormalities [C16]
Gender: Female, Male. Age: 0-17 years, 18-64 years, 65+ years. Enrolment: 55.
Status: Ongoing, recruitment ended. Start date (EU): 2022-11-02. Decision date: 2024-04-19. Results received: No. Last updated: 2026-07-13.
Decision dates by country: BE: 2024-04-22, BG: 2024-04-24, FR: 2024-04-23, DE: 2024-04-22, IT: 2024-05-14, ES: 2024-04-22, PL: 2024-04-29, NL: 2024-04-19

Condition(s): Hereditary Angioedema
Product: ISIS 721744

Primary endpoint: Incidence and severity of treatment-emergent adverse events (TEAEs).
Endpoint(s): 1. The time-normalized number of Investigator-confirmed HAE attacks (per month) from Week 1 to Week 53., 2. The time-normalized number of Investigator-confirmed HAE attacks (per month) from Week 5 to Week 53., 3. The percentage of Investigator-confirmed HAE attack-free patients from Week 5 to Week 53., 4. The time-normalized number of moderate or severe Investigator-confirmed HAE attacks (per month) from Week 5 to Week 53., 5. The number of Investigator-confirmed HAE attacks requiring acute therapy from Week 5 to Week 53., 6. Angioedema Quality of Life (AE-QoL) questionnaire total score over 53 weeks.

Source: https://euclinicaltrials.eu/ctis-public/view/2023-509201-77-00